EU clinical trial 2024-517412-29-00: Sacubitril/valsartan in the prevention of disease progression in patients with an ancient arrhythmogenic service - ARNI-ARVC multicentre randomized trial
Protocol code: 2021/ABM/01/00004
Sponsor: Narodowy Instytut Kardiologii Stefana Kardynala Wyszynskiego Panstwowy Instytut Badawczy (Hospital/Clinic/Other health care facility). Phase: Therapeutic confirmatory (Phase III). Countries: Poland (ongoing, recruiting).
Therapeutic area(s): Diseases [C] - Cardiovascular Diseases [C14]
Gender: Female, Male. Age: 18-64 years, 65+ years. Enrolment: 120.
Status: Ongoing, recruiting. Start date (EU): 2023-07-10. Decision date: 2024-10-31. Results received: No. Last updated: 2025-05-09.

Condition(s): arrhythmogenic in the old space of cardiomyopathy
Product: Entresto 24 mg/26 mg film-coated tablets, Entresto 49 mg/51 mg film-coated tablets, Entresto 97 mg/103 mg film-coated tablets

Primary endpoint: the degree of fibrosis of the left ventricular muscle in the CMR examination, left ventricular ejection fraction (LVEF) in CMR, ventricular arrhythmias load
Endpoint(s): NT-proBNP concentration and two fibrosis markers: sST2 and Gal-3, morphological and functional criteria (ECHO and CMR): the size of the left and right ventricles as well as generalized and focal contractility disorders, ECG: terminal activation delay (TAD) and extent of negative T waves in precordial leads, arrhythmias in the ECG, 24-hour Holter ECG recording, ergospirometry and ICD readings, physical capacity (pVO2) assessed on the basis of ergospirometric tests, hospitalization for symptoms of heart failure, sudden cardiac death

Source: https://euclinicaltrials.eu/ctis-public/view/2024-517412-29-00